EU clinical trial 2024-513839-24-00: A phase 3b, prospective, open-label, multicenter, single treatment arm, continuation study of the safety and efficacy of TAK-755 (rADAMTS-13, also know as BAX930/SHP655) in the prophylactic and on-demand treatment of subjects with severe congenital thrombotic thrombocytopenic purpura (cTTP; Upshaw-Schulman Syndrome, or hereditary thrombotic thrombocytopenic purpura)
Protocol code: TAK-755-3002
Sponsor: Baxalta Innovations GmbH (Pharmaceutical company). Phase: Therapeutic confirmatory (Phase III). Countries: France (ended), Germany (ended), Austria (ended), Italy (ended), Spain (ended), Poland (ended).
Therapeutic area(s): Diseases [C] - Hemic and Lymphatic Diseases [C15]
Gender: Female, Male. Age: 0-17 years, 18-64 years, 65+ years. Enrolment: 30.
Status: Ended. Start date (EU): 2021-09-07. End date (EU): 2025-11-21. Decision date: 2024-07-18. Results received: No. Last updated: 2026-02-23.
Decision dates by country: PL: 2024-07-18, ES: 2024-07-18, IT: 2024-08-05, DE: 2024-07-19, AT: 2024-07-22, FR: 2024-07-25

Condition(s): Congenital Thrombotic thrombocytopenic purpura (cTTP)
Product: RECOMBINANT ADAMTS13 (rADAMTS13), RECOMBINANT ADAMTS13 (rADAMTS13)

Primary endpoint: There is no primary efficacy endpoint for this study, as the primary objective of the study is long-term safety.
Endpoint(s): The key secondary efficacy outcome measure is the incidence of acute TTP events among subjects receiving TAK755 prophylactically. Analyses will be conducted using FAS for the prophylactic cohort. The number and incidence rate of acute TTP events will be summarized by enrollment status (""Naïve"" or having completed the Phase 3 pivotal study [Study 281102]) and overall.

Source: https://euclinicaltrials.eu/ctis-public/view/2024-513839-24-00